EU clinical trial 2024-518687-12-00: An Open-label Extension Study to Evaluate the Safety and Tolerability of Sotatercept (MK-7962) Administered Using a Weight-banded Approach in Participants With Pulmonary Arterial Hypertension (PAH) on Standard of Care.
Protocol code: MK-7962-031
Sponsor: Merck Sharp & Dohme LLC (Pharmaceutical company). Phase: Therapeutic exploratory (Phase II). Countries: Italy (ongoing, recruitment ended), Czechia (ongoing, recruitment ended), France (ongoing, recruitment ended), Hungary (ongoing, recruitment ended), Netherlands (ongoing, recruitment ended), Poland (ongoing, recruitment ended), Spain (ongoing, recruitment ended).
Therapeutic area(s): Diseases [C] - Cardiovascular Diseases [C14]
Gender: Female, Male. Age: 18-64 years, 65+ years. Enrolment: 67.
Status: Ongoing, recruitment ended. Start date (EU): 2025-06-19. Decision date: 2025-05-26. Results received: No. Last updated: 2026-08-06.
Decision dates by country: ES: 2025-05-28, PL: 2025-06-01, IT: 2025-05-30, FR: 2025-06-30, NL: 2025-05-26, CZ: 2025-05-30, HU: 2025-05-29

Condition(s): Pulmonary Arterial Hypertension (PAH)
Product: SOTATERCEPT, sotatercept, sotatercept, SOTATERCEPT

Primary endpoint: Number of participants with one or more adverse events (AEs), Number of participants who discontinue study intervention due to an AE

Source: https://euclinicaltrials.eu/ctis-public/view/2024-518687-12-00